EU clinical trial 2024-519922-19-00: PRODIGE 113 (FFCD 2314) – REWENEC – 01 STUDY Randomized trial of FOLFIRI + Zimberelimab + Domvanalimab vs FOLFIRI with a hybrid synthetic control arm in second line treatment of metastatic neuroendocrine carcinoma of gastro-enteropancreatic or unknown origin. Phase II comparative randomized study – multicentric
Protocol code: 69HCL24_0759
Sponsor: Hospices Civils De Lyon (Hospital/Clinic/Other health care facility). Phase: Therapeutic exploratory (Phase II). Countries: France (not authorised).
Therapeutic area(s): Diseases [C] - Neoplasms [C04]
Gender: Female, Male. Age: 18-64 years, 65+ years. Enrolment: 77.
Status: Not authorised. Decision date: 2026-02-22. Results received: No. Last updated: 2026-02-22.

Condition(s): Neuroendocrine carcinoma of gastro-enteropancreatic or unknown origin (GEP/UK NEC)
Product: IRINOTECAN, DOMVANALIMAB, FLUOROURACIL, Zimberelimab, CALCIUM LEVOFOLINATE

Primary endpoint: the overall survival defined as the length of time from randomization, that patients included in the study are still alive. Patients alive at last follow-up will be considered censored.
Endpoint(s): 12-months (6-months) overall survival rate defined as the percentage of patients included in the study who are still alive 12-months (6-months) after randomization., Progression-free survival (PFS), defined as the time from randomization to disease progression or death, whatever the cause. Alive and no progressive patients at last follow-up will be considered as censored., Objective response rate (ORR) by local radiological evaluation using RECIST 1.1, defined as the proportion of patients with RECIST 1.1 complete or partial response. Patients with no radiological evaluation and patients with non-evaluable RECIST 1.1 response will be excluded., Duration of Responses (DoR), defined as the time from response (complete or partial) to progression or death, estimated in patients who reached a response and are RECIST 1.1 evaluable., Disease control rate by local radiological evaluation using RECIST 1.1, defined as the proportion of RECIST 1.1 evaluable patients in objective response or with stable disease., Toxicity assessed by NCI CTCAE v5.0 grading,, Patients-reported outcomes according to EQ 5D-5L & QLQ-C30 questionnaire for patients recruited prospectively

Source: https://euclinicaltrials.eu/ctis-public/view/2024-519922-19-00